EU clinical trial 2023-504694-20-00: A phase I/II study of Inotuzumab Ozogamicin as a single agent and in combination with chemotherapy for pediatric CD22-positive relapsed/refractory Acute Lymphoblastic Leukemia
Sponsor: Erasmus Universitair Medisch Centrum Rotterdam (Erasmus MC) (Hospital/Clinic/Other health care facility). Phase: Phase I and Phase II (Integrated)- Other. Countries: Ireland (ongoing, recruitment ended), Belgium (ongoing, recruitment ended), Spain (ongoing, recruitment ended), Sweden (ongoing, recruitment ended), Finland (ended), Netherlands (ongoing, recruitment ended), Czechia (ongoing, recruitment ended), Germany (ongoing, recruitment ended), Denmark (ongoing, recruitment ended), Norway (ongoing, recruitment ended), Austria (ongoing, recruitment ended), France (ongoing, recruitment ended), Italy (ongoing, recruitment ended).
Therapeutic area(s): Diseases [C] - Hemic and Lymphatic Diseases [C15]
Gender: Female, Male. Age: 0-17 years. Enrolment: 142.
Start date (EU): 2017-01-13. Decision date: 2023-10-25. Results received: No. Last updated: 2026-06-04.
Decision dates by country: FI: 2023-10-30, IE: 2023-10-25, NO: 2023-10-26, BE: 2023-10-26, FR: 2023-11-15, SE: 2023-10-27, DK: 2023-10-25, CZ: 2023-10-27, NL: 2023-10-25, DE: 2023-11-06, IT: 2023-11-24, AT: 2023-10-30, ES: 2023-10-27

Condition(s): pediatric CD22-positive relapsed/refractory Acute Lymphoblastic Leukemia
Product: BESPONSA 1 mg powder for concentrate for solution for infusion

Primary endpoint: Stratum 1A : Dose-limiting toxicities (DLTs) during the first cycle of therapy., Phase 2 cohort: ORR, defined as the percentage of patients with CR, CRi, CRp, measured as best response during InO treatment (see Appendix 2 for definitions)., Stratum 1B and 1B-ASP: Dose-limiting toxicities (DLTs) during the first cycle of InO when added to a modified UKALL-R3 re-induction chemotherapy regimen without or with ASP., Stratum 2 Safety and tolerability: • AEs, as characterized by type, frequency, severity (as graded using CTCAE v4.03, timing, seriousness, and relation to study therapy, during the first and subsequent cycles of therapy., Stratum 2 Safety and tolerability: • Occurrence of toxic death; i.e., death attributable to InO therapy., Stratum 2 Safety and tolerability: • Occurrence of hepatic VOD/SOS during or after therapy with InO., Stratum 2 Safety and tolerability: • Laboratory abnormalities as characterized by type, frequency, severity and timing., Stratum 2 Safety and tolerability: • The cumulative incidence of non-relapse mortality, defined as the cumulative probability of non- relapse mortality, with time calculated between start of study treatment and death due to other causes than relapsed or refractory leukemia or lymphoma, accounting for competing events., Stratum 3: ORR, defined as the percentage of patients with CR, CRi, CRp, measured as best response of InO treatment (see Appendix 2 for definitions) as a single agent in CD22-positive VHR 1st relapse BCP ALL patients., Str4: ORR, defined as % of pts with CR, CRi, CRp, measured after course 1 of InO treatment as a single agent in patients with 2nd or greater CD22+ BCP-ALL relapse,1st VHR CD22+ BCP-ALL relapse, any relapse of BCP-ALL post allogeneic HSCT, and refractory disease, defined as newly diagnosed pts who are induction failures after at least 2 previous regimens without attainment of remission, or pts with refractory 1st relapse after 1 previous reinduction regimen without attainment of remission
Endpoint(s): Stratum 1A Safety and tolerability: • AEs, as characterized by type, frequency, severity (as graded using CTCAE, v4.03), timing, seriousness, and relation to study therapy, during the first and subsequent cycles of therapy., Stratum 1A Safety and tolerability: • Occurrence of toxic death; i.e., death attributable to InO therapy., Stratum 1A Safety and tolerability: • Occurrence of hepatic veno-occlusive disease (VOD)/sinusoidal obstruction syndrome (SOS) during or after therapy with InO., Stratum 1A Safety and tolerability: • Laboratory abnormalities as characterized by type, frequency, severity and timing., Stratum 1A Safety and tolerability: • The cumulative incidence of non-relapse mortality, defined as the cumulative probability of non- relapse mortality, with time calculated between start of study treatment and death due to other causes than relapsed or refractory leukemia or lymphoma, accounting for competing events., Stratum 1A Measures of anti-leukemic activity: • ORR, defined as CR, CRi, or CRp both after cycle 1 as well as the best response over multiple cycles of InO therapy (see Appendix 2 for definitions)., Stratum 1A Measures of anti-leukemic activity: • MRD levels, including the percentage of patients who become MRD-negative (complete MRD response defined as an MRD-level < 1x10-4), after cycle 1, as well as the overall best response (MRD-negativity) over multiple cycles., Stratum 1A Measures of anti-leukemic activity: • Duration of response, defined as the time between achieving response (CR, CRi or CRp) after starting study treatment and documented relapse or death., Stratum 1A Measures of anti-leukemic activity: • Number and percentage of patients being transplanted and those receiving CAR T-cell therapy after treatment with InO., Stratum 1A Measures of anti-leukemic activity: • EFS, defined as the time between start of study treatment and first event including failure to achieve CR/CRp/CRi (calculated as an event on day 0), relapse, death of any cause and second malignancies., Stratum 1A Measures of anti-leukemic activity:• Overall survival, defined as time to death following start of study treatment., Stratum 1A Measures of anti-leukemic activity:• The cumulative incidence of non-response or relapse, defined as the cumulative probability of non-response or relapse, with time calculated between start of study treatment and relapse and with non-responders included as an event on day 0. Non-relapse death is considered a competing event., Stratum 1A: Serum pharmacokinetic parameters of InO and unconjugated calicheamicin., Stratum 1A Pharmacodynamics parameters: • Relationship between response (ORR) and CD22 expression levels and WBC., Stratum 1A Pharmacodynamics parameters: • Relationship between response (ORR) and CD22 saturation kinetics., Stratum 1A Pharmacodynamics parameters: • Relationship between response (ORR) and calicheamicin sensitivity., Stratum 1A Pharmacodynamics parameters:• Clonal evolution (CD22-negativity) and relation to loss of response., Stratum 1A Other endpoints: • The percentage of patients responding to InO (ORR) without adequate recovery of CD19-positive B-cells (below lower limit of normal (LLN) for age) or immunoglobulins (below LLN for age). Following 4 weeks, 10 weeks, 3, 6 and 12 months after treatment with InO, excluding patients who have been transplanted from the date of HSCT or have received CAR-T cells therapy., Stratum 1A Other endpoints: • Percentage of patients who exhibit anti-drug antibodies (ADA) (NOT valid for patients enrolled after Amendment 4)., Phase 2 cohort Safety: • AEs, as characterized by type, frequency, severity (as graded using CTCAE v4.03), timing, seriousness, and relation to study therapy, during the first and subsequent cycles of therapy., Phase 2 cohort Safety: Occurrence of toxic death; i.e., death attributable to InO therapy., Phase 2 cohort Safety:• Occurrence of VOD/SOS during or after therapy with InO., Phase 2 cohort Safety: • Laboratory abnormalities as characterized by type, frequency, severity and timing., Phase 2 cohort Safety: • The cumulative incidence of non-relapse mortality, defined as the cumulative probability of non- relapse mortality, with time calculated between start of study treatment and death due to other causes than relapsed or refractory leukemia or lymphoma, accounting for competing events., Phase 2 cohort Other measures of anti-leukemic activity: • ORR after cycle 1., Phase 2 cohort Other measures of anti-leukemic activity: • Minimal residual disease levels, including the percentage of patients who become MRD-negative (complete MRD response defined as an MRD-level < 1x10-4), after cycle 1, as well as the best response (MRD-negativity) over multiple cycles., Phase 2 cohort Other measures of anti-leukemic activity: Duration of response, defined as the time between achieving response (CR, CRi or CRp) after starting study treatment and documented relapse or death., Phase 2 cohort Other measures of anti-leukemic activity: • Number and percentage of patients being transplanted and those receiving CAR T-cell therapy after treatment with InO., Phase 2 cohort Other measures of anti-leukemic activity: • EFS, defined as the time between start of study treatment and first event including failure to achieve CR/CRp/CRi (calculated as an event on day 0), relapse, death of any cause and second malignancies., Phase 2 cohort Other measures of anti-leukemic activity:• Survival, defined as time to death following start of study treatment., Phase 2 cohort Other measures of anti-leukemic activity:• The cumulative incidence of non-response or relapse, defined as the cumulative probability of non-response or relapse, with time calculated between start of study treatment and relapse and with non-responders included as an event on day 0. Non-relapse death is considered a competing event., Phase 2 cohort Serum pharmacokinetic parameters of InO and unconjugated calicheamicin., Phase 2 cohort Pharmacodynamics parameters:• Relationship between response (ORR) and CD22 expression levels and WBC., Phase 2 cohort Pharmacodynamics parameters:• Relationship between response (ORR) and CD22 saturation kinetics., Phase 2 cohort Pharmacodynamics parameters:• Relationship between response (ORR) and calicheamicin sensitivity., Phase 2 cohort Pharmacodynamics parameters:• Clonal evolution (CD22-negativity) and relation to loss of response., Phase 2 cohort Other endpoints: • The percentage of patients responding to InO (ORR) without adequate recovery of CD19-positive B-cells (below LLN for age) or immunoglobulins (below LLN for age) following 4 weeks, 10 weeks, 3, 6 and 12 months after treatment with InO, excluding patients who have been transplanted from the date of HSCT or have received CAR-T cells therapy. Percentage of patients who exhibit ADA (NOT valid for patients enrolled after Amendment 4)., Stratum 1B and 1B-ASP Safety: • AEs (secondary endpoints have same definitions as for Stratum 1A), Stratum 1B and 1B-ASP Safety: • Occurrence of toxic death; i.e., death attributable to InO therapy., Stratum 1B and 1B-ASP Safety: • Occurrence of hepatic VOD/SOS during or after therapy with InO., Stratum 1B and 1B-ASP Safety: • Laboratory abnormalities, Stratum 1B and 1B-ASP Safety: • Cumulative incidence of non-relapse mortality, Stratum 1B and 1B-ASP Other measures of anti-leukemic activity: • ORR, Stratum 1B and 1B-ASP Other measures of anti-leukemic activity: • MRD levels, Stratum 1B and 1B-ASP Other measures of anti-leukemic activity: • Duration of response, Stratum 1B and 1B-ASP Other measures of anti-leukemic activity: • Number and percentage of patients being transplanted and those receiving CAR T-cell therapy after treatment with InO., Stratum 1B and 1B-ASP Other measures of anti-leukemic activity: • EFS, Stratum 1B and 1B-ASP Other measures of anti-leukemic activity: • Overall survival, Stratum 1B and 1B-ASP Other measures of anti-leukemic activity: • Cumulative incidence of non-response or relapse, Stratum 1B and 1B-ASP Serum pharmacokinetic parameters of InO and unconjugated calicheamicin during treatment combined with modified UKALL-R3 re-induction regimen both with and without pegylated asparaginase., Stratum 1B and 1B-ASP Pharmacodynamics parameters • Relationship between response (ORR) and CD22 expression levels, Stratum 1B and 1B-ASP Pharmacodynamics parameters • Clonal evolution (CD22-negativity) and relation to loss of response., Stratum 2 Measures of anti-tumor activity: • Overall remission rate (CR and PR) both after cycle 1 as well as overall best response in patients receiving multiple cycles of InO therapy (see Appendix 2 for definitions)., Stratum 2 Measures of anti-tumor activity:• Duration of response, defined as the time between achieving response (CR and PR) after starting study treatment and documented relapse or death., Stratum 2 Measures of anti-tumor activity: • Number and percentage of patients being transplanted and those receiving CAR T-cell therapy after treatment with InO., Stratum 2 Measures of anti-tumor activity: • EFS, defined as the time between start of study treatment and first event including failure to achieve CR/PR (calculated as an event on day 0), relapse, death of any cause and second malignancies., Stratum 2 Measures of anti-tumor activity: • Overall survival, defined as time to death following start of study treatment., Stratum 2 Measures of anti-tumor activity: • The cumulative incidence of non-response or relapse, defined as the cumulative probability of non-response or relapse, with time calculated between start of study treatment and relapse and with non-responders included as an event on day 0. Non-relapse death is considered a competing event., Stratum 2 Serum pharmacokinetic parameters of InO and unconjugated calicheamicin., Stratum 2 Other endpoints: • The percentage of patients responding to InO (ORR) without adequate recovery of CD19-positive B-cells (below LLN for age) or immunoglobulins (below LLN for age) following 4 weeks, 10 weeks, 3, 6 and 12 months after treatment with InO, excluding patients who have been transplanted from the date of HSCT or have received CAR-T cells therapy., Stratum 2 Other endpoints: • Percentage of patients who exhibit ADA (NOT valid for patients enrolled after Amendment 4)., Stratum 3 Safety: • AEs, as characterized by type, frequency, severity (as graded using CTCAE v4.03), timing, seriousness, and relation to study therapy, during the first and subsequent cycles of therapy., Stratum 3 Safety:• Occurrence of any induction death and/or toxic death attributable to InO therapy., Stratum 3 Safety:• Occurrence of VOD/SOS during or after therapy with InO., Stratum 3 Safety: • Laboratory abnormalities as characterized by type, frequency, severity and timing., Stratum 3 Safety: • The cumulative incidence of non-relapse mortality, defined as the cumulative probability of non- relapse mortality, with time calculated between start of study treatment and death due to other causes than relapsed or refractory leukemia or lymphoma, accounting for competing events., Stratum 3 Other measures of anti-leukemic activity: • ORR after cycle 1, Stratum 3 Other measures of anti-leukemic activity:• Minimal residual disease levels, including the percentage of patients who become MRD-negative (complete MRD response defined as an MRD-level < 1x10-4) after cycle 1, as well as the best response (MRD-negativity) over multiple cycles., Stratum 3 Other measures of anti-leukemic activity:• Duration of response, defined as the time between achieving response (CR, CRi or CRp) after starting study treatment and documented relapse or death., Stratum 3 Other measures of anti-leukemic activity:• Number and percentage of patients being transplanted and those receiving CAR T-cell therapy after treatment with InO., Stratum 3 Other measures of anti-leukemic activity: • EFS, defined as the time between start of study treatment and first event including failure to achieve CR/CRp/CRi (calculated as an event on day 0), relapse, death of any cause and second malignancies., Stratum 3 Other measures of anti-leukemic activity: • Survival, defined as time to death following start of study treatment., Stratum 3 Other measures of anti-leukemic activity:• The cumulative incidence of non-response or relapse, defined as the cumulative probability of non-response or relapse, with time calculated between start of study treatment and relapse and with non-responders included as an event on day 0. Non-relapse death is considered a competing event., Stratum 3 Other measures of anti-leukemic activity: • To study the interval between InO re-induction and CAR-T cells therapy based on MRD negativity and B cell aplasia after InO re-induction., Stratum 3 Pharmacodynamics parameters • Relationship between response (ORR) and CD22 expression levels and WBC., Stratum 3 Pharmacodynamics parameters • Relationship between response (ORR) and calicheamicin sensitivity., Stratum 3 Pharmacodynamics parameters • Clonal evolution (CD22-negativity) and relation to loss of response., Stratum 3 Other endpoints • The percentage of patients responding to InO (ORR) without adequate recovery of CD19-positive B-cells and CD4+/CD8+ T-cells(below LLN for age) or immunoglobulins (below LLN for age) following 4,6,8 and 10 weeks, 3, 6 and 12 months after treatment with InO, excluding patients who have been transplanted from the date of HSCT or CAR T-cell infusion., Stratum 4 Safety and tolerability: AEs, as characterized by type, frequency, severity (as graded using CTCAE v4.03), timing, seriousness, and relation to study therapy, during the first and subsequent courses of therapy., Stratum 4 Safety and tolerability: Occurrence of toxic death; i.e., death attributable to InO therapy., Stratum 4 Safety and tolerability: Occurrence of VOD/SOS during or after therapy with InO, Stratum 4 Safety and tolerability: Laboratory abnormalities as characterized by type, frequency, severity and timing., Stratum 4 Safety and tolerability: The cumulative incidence of non-relapse mortality, defined as the cumulative probability of non-relapse mortality, with time calculated between start of study treatment and death due to other causes than relapsed or refractory leukemia or lymphoma, accounting for competing events., Stratum 4 Other measures of anti-leukemic activity: ORR after cycle 1., Stratum 4 Other measures of anti-leukemic activity: Minimal residual disease levels, including the percentage of patients who become MRD-negative (complete MRD response defined as an MRD-level < 1x10-4) after cycle 1, as well as the best response (MRD-negativity) over multiple cycles., Stratum 4 Other measures of anti-leukemic activity: Duration of response, defined as the time between achieving response (CR, CRi or CRp) after starting study treatment and documented relapse or death., Stratum 4 Other measures of anti-leukemic activity: Number and percentage of patients being transplanted and those receiving CAR T-cell therapy after treatment with InO., Stratum 4 Other measures of anti-leukemic activity: EFS, defined as the time between start of study treatment and first event including failure to achieve CR/CRp/CRi (calculated as an event on day 0), relapse, death of any cause and second malignancies., Stratum 4 Other measures of anti-leukemic activity: Survival, defined as time to death following start of study treatment., Stratum 4 Other measures of anti-leukemic activity: The cumulative incidence of non-response or relapse, defined as the cumulative probability of non-response or relapse, with time calculated between start of study treatment and relapse and with non-responders included as an event on day 0. Non-relapse death is considered a competing event., Stratum 4 Other measures of anti-leukemic activity: To study the interval between InO re-induction and CAR-T cells therapy based on MRD negativity and B cell aplasia after InO re-induction., Stratum 4 Pharmacodynamics parameters: Relationship between response (ORR) and CD22 expression levels and WBC., Stratum 4 Pharmacodynamics parameters: Clonal evolution (CD22-negativity) and relation to loss of response., Stratum 4 Pharmacodynamics parameters: Screening through whole genome sequencing of genomic determinants of response/resistance to InO, assessing the relationship between response (ORR and MRD negativity) and DNTT expression levels, cytogenetics, as well as other emerging mechanisms of resistance., Stratum 4 Other endpoints: The percentage of patients responding to InO (ORR) without adequate recovery of CD19-positive B-cells and CD4+/CD8+ T-cells(below LLN for age) or immunoglobulins (below LLN for age) following 4,6,8 and 10 weeks, 3, 6 and 12 months after treatment with InO, excluding patients who have been transplanted from the date of HSCT or CAR T-cell infusion.

Source: https://euclinicaltrials.eu/ctis-public/view/2023-504694-20-00